EU clinical trial 2024-511115-25-00: A Randomized, Double-blind, Placebo-controlled Phase 2 Study with Open-label Extension to Assess the Efficacy and Safety of Namilumab in Subjects with Chronic Pulmonary Sarcoidosis
Protocol code: KIN-1902-2001
Sponsor: Kinevant Sciences GmbH (Pharmaceutical company). Phase: Therapeutic exploratory (Phase II). Countries: Germany (ended), France (ended), Netherlands (ended), Belgium (ended).
Therapeutic area(s): Diseases [C] - Immune System Diseases [C20]
Gender: Female, Male. Age: 18-64 years, 65+ years. Enrolment: 33.
Status: Ended. Start date (EU): 2022-11-21. End date (EU): 2025-03-31. End date: 2025-04-09. Decision date: 2024-03-28. Results received: Yes. Last updated: 2024-12-05.
Decision dates by country: BE: 2024-04-05, FR: 2024-03-28, NL: 2024-03-28, DE: 2024-04-01

Condition(s): chronic pulmonary sarcoidosis
Product: placebo, Namilumab

Primary endpoint: Proportion of subjects with a rescue event during DB period.
Endpoint(s): Change from baseline in percent predicted forced vital capacity (ppFVC) at Week 26;, Time to first rescue event during DB period;, Proportion of subjects successfully achieving OCS taper without rescue event during DB period;, Change from baseline in the KSQ Lung domain score at Week 26;, Safety and tolerability, including assessment of physical examinations (PEs), vital signs, electrocardiograms (ECGs), clinical laboratory measurements, and AEs during DB period;

Source: https://euclinicaltrials.eu/ctis-public/view/2024-511115-25-00